EU clinical trial 2023-507119-36-00: An Open-Label, Randomized, Controlled Multi-Center Study of The Efficacy of Daromun (L19IL2 + L19TNF) Neoadjuvant Intratumoral Treatment Followed by Surgery and Adjuvant Therapy Versus Surgery and Adjuvant Therapy in Clinical Stage IIIB/C Melanoma Patients
Protocol code: PH-L19IL2TNF-01/18
Sponsor: Philogen S.p.A. (Pharmaceutical company). Phase: Therapeutic confirmatory (Phase III). Countries: Spain (ongoing, recruiting), Germany (ongoing, recruiting), Italy (authorised, recruiting), Sweden (authorised, recruiting).
Therapeutic area(s): Diseases [C] - Neoplasms [C04]
Gender: Female, Male. Age: 18-64 years, 65+ years. Enrolment: 170.
Start date (EU): 2022-05-09. Decision date: 2023-08-01. Results received: No. Last updated: 2026-02-18.
Decision dates by country: ES: 2023-08-01, DE: 2026-02-18, IT: 2026-02-12, SE: 2026-02-06

Condition(s): Malignant melanoma of the skin in patients with locally advanced and fully resectable melanoma with/without prior therapy and presence of injectable cutaneous and/or subcutaneous or nodal lesions
Product: Fibromun, Darleukin

Primary endpoint: Primary endpoint of the study is recurrence free survival (RFS) in a time-to-event analysis in the Daromun plus surgery and adjuvant therapy treatment group (Arm 1) versus the surgery and adjuvant therapy control group (Arm 2). Analysis will be performed for the "Intention To Treat" population
Endpoint(s): The key secondary objective of the study is Overall Survival (OS) with the aim to demonstrate the statistical superiority of Daromun plus surgery and adjuvant therapy with respect to surgery and adjuvant therapy. Other secondary objectives include improvement of RFS as determined by the local investigator, local recurrence-free survival (LRFS) and distant metastasis-free survival (DMFS) and, for patients in Arm 1 only, pathological responses

Source: https://euclinicaltrials.eu/ctis-public/view/2023-507119-36-00